EU clinical trial 2024-512831-66-00: A Multicenter, Open-label, Interventional Phase I Trial to Determine the Dose and Evaluate the Pharmacokinetics (PK) and Safety of Lutetium Lu 177 Edotreotide Targeted Radiopharmaceutical Therapy (RPT) as Monotherapy or Following Standard of Care (SoC) for the Treatment of Somatostatin Receptor-positive Tumors in the Pediatric Population (KinLET)
Protocol code: ITM-1191-01
Sponsor: ITM Solucin GmbH (Pharmaceutical company). Phase: Human Pharmacology (Phase I)- Other. Countries: Italy (authorised, recruitment pending), Spain (ongoing, recruiting), France (authorised, recruiting).
Therapeutic area(s): Diseases [C] - Hemic and Lymphatic Diseases [C15]; Diseases [C] - Neoplasms [C04]
Gender: Female, Male. Age: 0-17 years. Enrolment: 16.
Start date (EU): 2025-10-24. Decision date: 2025-03-19. Results received: No. Last updated: 2026-03-20.
Decision dates by country: ES: 2025-04-24, IT: 2025-03-19, FR: 2025-07-29

Condition(s): Pediatric participants aged two to less than 18 years old with somatostatin receptor positive (SSTR-positive) solid tumors or lymphoma, recurrent/refractory to at least one prior line of therapy
Product: Arginine-Lysine solution for infusion, 177Lu-Edotreotide

Primary endpoint: Determine the recommended dosage defined as the highest lutetium Lu 177 edotreotide dose which will comply with all the following criteria: 1. The median kidney absorbed dose of lutetium Lu-177 edotreotide is below 23 Gy for full treatment. 2. The median bone marrow absorbed dose is below 2 Gy for full treatment 3. Acceptable dose- limiting toxicity (DLT) profile (based on adverse event reporting) as evaluated by the safety monitoring committee (SMC).
Endpoint(s): Objective -response rate (ORR): proportion of targeted RPT-treated participants with a complete response (CR) or partial response (PR), evaluated by the Investigator, under consideration of available guidelines for monitoring response in the different tumors involved (please see protocol for further details)., Rate of AEs: occurrence of AEs, severity, seriousness, AEs of special interest (AESIs), outcome, treatment/trial procedure-relatedness, action taken (including any treatment, and including any change in administration of theinvestigational medicinal product [IMP]),dose-modifying toxicity (DMT), DLT. Please see the protocol for assessments that will be performed to evaluate the safety of lutetium Lu 177 edotreotide., Overall survival (OS) Progression-free survival (PFS) and duration of response (DoR) According to Investigator’s criteria, based on anatomical/functional imaging magnetic resonance imaging (MRI) and/or CT and/or positron emission tomography (PET)/CT and/or PET/MRI and/or SPECT/CT), according to the current guidelines appropriate for the applicable histology or tumor types, The following assessments, done in cycles 1 and 2. For cycle 4, reduced number of measurements might be performed based on cycle 1 and 2 data: 1.Full 3D SPECT/low dose CT imaging of one or multiple bed-positions (depending on the height of the participants) 2.Whole body planar imaging (fast acquisition using a gamma camera). 3.Blood radioactivity concentration measurements. Please see protocol for further details.

Source: https://euclinicaltrials.eu/ctis-public/view/2024-512831-66-00